EU clinical trial 2023-508444-22-01: An ascending dose study to determine the safety and effect of antibodies against hepatitis B (The SAMBA Study)
Protocol code: SAMBA-001
Sponsor: Region Midtjylland (Hospital/Clinic/Other health care facility). Phase: Human Pharmacology (Phase I)- First administration to humans. Countries: Denmark (ongoing, recruiting), Germany (ongoing, recruiting).
Therapeutic area(s): Diseases [C] - Virus Diseases [C02]
Gender: Female, Male. Age: 18-64 years, 65+ years. Enrolment: 48.
Status: Ongoing, recruiting. Start date (EU): 2024-08-26. Decision date: 2024-06-28. Results received: No. Last updated: 2026-07-30.
Decision dates by country: DE: 2024-09-16, DK: 2024-06-28

Condition(s): Chronic hepatitis B infection

Source: https://euclinicaltrials.eu/ctis-public/view/2023-508444-22-01